EU clinical trial 2023-503290-38-00: A randomised, double-blind, parallel group, roll-over study evaluating long-term safety and efficacy of oral doses of BI 1291583 q.d. in patients with bronchiectasis (ClairleafTM)
Protocol code: 1397-0017
Sponsor: Boehringer Ingelheim International GmbH, Boehringer Ingelheim RCV GmbH & Co. KG, Boehringer Ingelheim Espana S.A. (Industry, Pharmaceutical company, Pharmaceutical company). Phase: Therapeutic exploratory (Phase II). Countries: Netherlands (ongoing, recruitment ended), Hungary (ongoing, recruitment ended), Portugal (ongoing, recruitment ended), Czechia (ongoing, recruitment ended), Italy (ongoing, recruitment ended), France (ongoing, recruitment ended), Latvia (ongoing, recruitment ended), Germany (ongoing, recruitment ended), Greece (ended), Belgium (ongoing, recruitment ended), Poland (ongoing, recruitment ended), Denmark (ongoing, recruitment ended), Spain (ongoing, recruitment ended), Bulgaria (ongoing, recruitment ended).
Therapeutic area(s): Diseases [C] - Respiratory Tract Diseases [C08]
Gender: Female, Male. Age: 18-64 years, 65+ years. Enrolment: 114.
Start date (EU): 2023-09-05. Decision date: 2023-08-29. Results received: No. Last updated: 2026-07-28.
Decision dates by country: GR: 2023-08-30, BE: 2023-12-05, BG: 2023-09-04, CZ: 2023-08-31, DK: 2023-08-29, ES: 2023-08-30, FR: 2023-08-30, HU: 2023-09-01, IT: 2023-09-01, LV: 2023-08-31, NL: 2023-08-29, PL: 2023-09-04, PT: 2023-08-29, DE: 2023-09-04

Condition(s): Bronchiectasis
Product: SALBUTAMOL SULFATE, Placebo matching to BI 1291583 1 mg, Placebo matching to BI 1291583 5 mg, BI 1291583 2.5 mg, BI 1291583 1 mg, BI 1291583 5 mg, Placebo matching to BI 1291583 2.5 mg

Primary endpoint: Occurrence of treatment-emergent AEs (TEAEs) over the course of this trial
Endpoint(s): Time to first pulmonary exacerbation from first drug administration in this trial to the end of the trial, Rate of pulmonary exacerbations (number of events per person-time) over the course of this trial

Source: https://euclinicaltrials.eu/ctis-public/view/2023-503290-38-00